EU clinical trial 2024-519700-28-01: The HIt HArd and hiT early in multiple sclerosis trial – HiHat trial
Protocol code: HiHat
Sponsor: Region Uppsala (Hospital/Clinic/Other health care facility). Phase: Therapeutic exploratory (Phase II). Countries: Sweden (authorised, recruitment pending).
Therapeutic area(s): Diseases [C] - Nervous System Diseases [C10]
Gender: Female, Male. Age: 18-64 years. Enrolment: 50.
Status: Authorised, recruitment pending. Decision date: 2025-10-22. Results received: No. Last updated: 2025-10-22.

Condition(s): Patients with relapsing-remitting multiple sclerosis with less than 10 years disease duration.
Product: ACICLOVIR, CETIRIZINE, METHYLPREDNISOLONE, RITUXIMAB, CLADRIBINE, SULFAMETHOXAZOLE AND TRIMETHOPRIM, PARACETAMOL

Primary endpoint: The binary indicator of at least one treatment-related SAE (relationship ≥ possible) per participant.
Endpoint(s): Proportion of patients with a new MRI lesion at end of follow-up; and the average number of new T2 lesions per patient., Proportion of patients with a new relapse; and the proportion of patients with a steroid-treated relapse; and the annualized relapse rate during follow-up,, Proportion of patients with confirmed disability worsening; and the average change in EDSS (Expanded Disability Status Scale); and proportion of patients with worsened/unchanged/improved SDMT; and the average change in SDMT., The average change in pNfL and pGFAp., Proportion of patients with improved MSIS-29; and the average change in MSIS-29., Proportion of patients with mild/moderate adverse events with at least a probable relationship to the study medication (adverse reaction)

Source: https://euclinicaltrials.eu/ctis-public/view/2024-519700-28-01